EU clinical trial 2023-503905-12-00: An Open-label, Multicenter, Phase 2 Study to Evaluate the Efficacy and Safety of Pembrolizumab Plus Lenvatinib in Combination With Belzutifan in Multiple Solid Tumors
Protocol code: MK-6482-016
Sponsor: Merck Sharp & Dohme LLC (Pharmaceutical company). Phase: Therapeutic exploratory (Phase II). Countries: Netherlands (ended), France (ended), Belgium (ended), Spain (ended).
Therapeutic area(s): Diseases [C] - Neoplasms [C04]
Gender: Female, Male. Age: 18-64 years, 65+ years. Enrolment: 104.
Status: Ended. Start date (EU): 2021-08-20. End date (EU): 2026-06-16. Decision date: 2023-10-30. Results received: No. Last updated: 2026-05-22.
Decision dates by country: NL: 2023-10-30, FR: 2023-10-31, ES: 2023-10-30, BE: 2023-10-30

Condition(s): Liver cancer; Colon cancer; Pancreatic cancer; Bile Duct or Gallbladder cancer; Endometrial cancer; Esophageal cancer
Product: Lenvatinib, KEYTRUDA 25 mg/mL concentrate for solution for infusion, Belzutifan, Lenvatinib

Primary endpoint: Number of Participants in Lead-in Phase Who Experience at Least One Dose-limiting Toxicity (DLT), Number of Participants in Arm 1/Triplet Who Experience at Least One Adverse Event (AE), Number of Participants in Arm 1/Triplet Who Discontinue Study Treatment Due to an AE, Objective Response Rate Per Response Criteria in Solid Tumors Version 1.1 (RECIST 1.1) as Assessed by Blinded Independent Central Review (BICR)
Endpoint(s): Duration of Response (DOR) Per RECIST 1.1 as Assessed by BICR, Disease Control Rate (DCR) Per RECIST 1.1 as Assessed by BICR, Progression-free Survival (PFS) Per RECIST 1.1 as Assessed by BICR, Overall Survival (OS), ORR Per Modified Response Criteria in Solid Tumors Version 1.1 (mRECIST 1.1) for Hepatocellular Carcinoma (HCC) as Assessed by BICR, DOR Per mRECIST 1.1 for HCC as Assessed by BICR, DCR Per mRECIST 1.1 for HCC as Assessed by BICR, PFS Per mRECIST 1.1 for HCC as Assessed by BICR, Number of Participants in Arm 2/Doublet Who Experience at Least One AE, Number of Participants in Arm 2/Doublet Who Discontinue Study Treatment Due to an AE

Source: https://euclinicaltrials.eu/ctis-public/view/2023-503905-12-00